EU clinical trial 2024-515218-42-00: A first-in-human study to determine the safety and tolerability of different doses of GEH200520 Injection and GEH200521 (18F) Injection and their uses in positron emission tomography imaging for patients with cancer
Protocol code: GE-269-001
Sponsor: GE Healthcare Limited (Pharmaceutical company). Phase: Human Pharmacology (Phase I)- First administration to humans. Countries: Netherlands (ended).
Therapeutic area(s): Analytical, Diagnostic and Therapeutic Techniques and Equipment [E] - Diagnosis [E01]; Diseases [C] - Neoplasms [C04]
Gender: Female, Male. Age: 18-64 years, 65+ years. Enrolment: 50.
Status: Ended. Start date (EU): 2025-01-23. End date (EU): 2026-07-31. Decision date: 2024-07-03. Results received: No. Last updated: 2026-06-05.

Condition(s): Irresectable or metastatic solid tumour or a local and resectable head and neck squamous cell carcinoma

Source: https://euclinicaltrials.eu/ctis-public/view/2024-515218-42-00